EU clinical trial 2024-518818-53-00: Multicenter, controlled, randomized, observer-blinded clinical trial to evaluate the efficacy and safety of insulin eye drops (1 IU/ml) in the treatment of persistent corneal epithelial defect.
Protocol code: INSULINADEP-22
Sponsor: Hospital Clinico San Carlos (Hospital/Clinic/Other health care facility). Phase: Therapeutic confirmatory (Phase III). Countries: Spain (ongoing, recruiting).
Therapeutic area(s): Diseases [C] - Eye Diseases [C11]
Gender: Female, Male. Age: 18-64 years, 65+ years. Enrolment: 234.
Status: Ongoing, recruiting. Start date (EU): 2023-09-26. Decision date: 2024-11-06. Results received: No. Last updated: 2026-01-20.

Condition(s): Persistent corneal epithelial defect.
Product: INSULIN (HUMAN)

Primary endpoint: Closure or non-closure of the persistent epithelial defect, expressed as percentage of patients with complete re-epithelialisation., Closure rate (area of initial defect / days to epithelialisation, in mm2/day)., Time to complete closure (in days) (closure in first two weeks of treatment: complete success; closure in first month of treatment: partial success).
Endpoint(s): Percentage of patients with insufficient response., Percentage of patients with treatment failure., Description of other variables and relationship with response: age, sex, comorbidities, aetiology of the epithelial defect, time since diagnosis, previous treatment, previous surgeries, visual acuity., Closure or not of the PED and rate of closure in those patients who receive both treatments due to insufficient effect of one of them in isolation.

Source: https://euclinicaltrials.eu/ctis-public/view/2024-518818-53-00